EU clinical trial 2024-511433-35-00: EVALUATION OF THE EFFICACY OF TOLCAPONE AS A GENOTYPE-BASED TARGETED COGNITIVE ENHANCER IN SCHIZOPHRENIA, BASED ON THE POLYMORPHISM RS4680
Protocol code: rs4680-tolcapona
Sponsor: Clinica Universidad De Navarra (Hospital/Clinic/Other health care facility). Phase: Therapeutic exploratory (Phase II). Countries: Spain (ended).
Therapeutic area(s): Psychiatry and Psychology [F] - Mental Disorders [F03]
Gender: Female, Male. Age: 18-64 years. Enrolment: 20.
Status: Ended. End date (EU): 2026-04-27. Decision date: 2024-05-14. Results received: No. Last updated: 2024-05-14.

Condition(s): SCHIZOPHRENIA
Product: Tasmar 100 mg film-coated tablets

Primary endpoint: Performance in the DPX cognitive test and in the modified MATRICS battery (number of errors and response times) 2) Brain activation elicited during functional brain MRI (fMRI) (relative degree of activation of different brain regions): BOLD response
Endpoint(s): Efficacy: scores on clinical scales (PANSS, NSA-16, BPRS, ICG, GAF, Ham A, Ham D, Psychosis Severity Dimensions)., Patient reported outcomes: POMS, visual analogue scales, Plasma homocysteine value

Source: https://euclinicaltrials.eu/ctis-public/view/2024-511433-35-00